EU clinical trial 2024-512511-49-00: SAKK 66/22: Intratumoral INT230-6 followed by neoadjuvant immuno-chemotherapy in patients with early triple-negative breast cancer (TNBC). An open-label randomized two-cohort phase 2 clinical trial. INVINCIBLE-4-SAKK
Protocol code: U1111-1305-0044
Sponsor: Swiss Cancer Institute (Patient organisation/association). Phase: Therapeutic exploratory (Phase II). Countries: France (authorised, recruitment pending).
Therapeutic area(s): Diseases [C] - Neoplasms [C04]
Gender: Female, Male. Age: 18-64 years, 65+ years. Enrolment: 29.
Status: Authorised, recruitment pending. Decision date: 2025-04-23. Results received: No. Last updated: 2026-07-02.

Condition(s): Early triple-negative breast cancer (TNBC)

Primary endpoint: Pathological complete response (pCR) in the primary tumor (ypT0/Tis) and affected lymph nodes (ypN0).
Endpoint(s): pCR (invasive and in-situ, only invasive, respectively) in the breast, pCR in lymph nodes, Pattern of non pCR, Radiological response according to RECIST v1.1, Radiological tumor response using two perpendicular diameters, EFS, Rate of breast conserving surgery (BCS) at the time of definitive surgery, Surgery conversion rates, Adverse events according to National Cancer institute (NCI) Common Terminology Criteria for Adverse Events (CTCAE) v5.0

Source: https://euclinicaltrials.eu/ctis-public/view/2024-512511-49-00